EU clinical trial 2025-521810-24-00: Pilot study to explore the diagnostic value of gadopiclenol in pathological and radiological insights with multiparametric MRI enhancement in breast cancer.
Protocol code: GAPI-PRIME
Sponsor: Fundacion Ribera Salud (Laboratory/Research/Testing facility). Phase: Therapeutic use (Phase IV). Countries: Spain (ended).
Therapeutic area(s): Analytical, Diagnostic and Therapeutic Techniques and Equipment [E] - Diagnosis [E01]
Gender: Female. Age: 18-64 years, 65+ years. Enrolment: 30.
Status: Ended. Start date (EU): 2025-09-22. End date (EU): 2026-02-19. Decision date: 2025-09-05. Results received: No. Last updated: 2026-02-18.

Condition(s): Breast cancer
Product: Elucirem 0.5 mmol/mL solution for injection

Primary endpoint: Evaluate the correlation between the multiparametric magnetic resonance imaging lesion characteristics (size, type of lesion, morphology, enhancement pattern and kinetics, laterality and location of primary tumor) and histopathological tumor parameters (size, grade, histological type, lymph node status, lymphovascular invasion, nodal metastases and molecular subtype).
Endpoint(s): Diagnostic accuracy of gadopiclenol in detecting and characterizing multiplicity of breast cancer lesions., Assessment of BPE patterns (minimal, mild, moderate and marked) and their influence on lesion visibility., Assessment of the safety profile by collecting the adverse events during the study.

Source: https://euclinicaltrials.eu/ctis-public/view/2025-521810-24-00